EU clinical trial 2024-519997-37-00: Prevention of cardiac surgery-associated acute kidney injury through the use of sodium-glucose cotransporter 2 inhibitors
Sponsor: Hospital Clinico Universitario De Valladolid (Hospital/Clinic/Other health care facility). Phase: Therapeutic confirmatory (Phase III). Countries: Spain (authorised, recruitment pending).
Therapeutic area(s): Diseases [C] - Cardiovascular Diseases [C14]; Diseases [C] - Nutritional and Metabolic Diseases [C18]
Gender: Female, Male. Age: 18-64 years, 65+ years. Enrolment: 608.
Status: Authorised, recruitment pending. Decision date: 2025-01-16. Results received: No. Last updated: 2025-01-16.

Condition(s): Cardiac-surgery associated acute kidney injury
Product: Jardiance 10 mg film-coated tablets, MICROCRYSTALLINE CELLULOSE

Primary endpoint: Composite endpoint of worsening of renal function, defined as a decline in estimated glomerular filtration rate (eGFR) of ≥25%, renal replacement therapy initiation or death during the first 90 days following surgery

Source: https://euclinicaltrials.eu/ctis-public/view/2024-519997-37-00